EU clinical trial 2024-515279-37-00: A Phase 3, Randomized, Open-Label, Multicenter Study to Compare the Efficacy and Safety of Arlocabtagene Autoleucel (BMS-986393), a GPRC5D-directed CAR-T Cell Therapy, Versus Standard Regimens in Adult Participants with Relapsed or Refractory and Lenalidomide-exposed Multiple Myeloma (QUINTESSENTIAL-2)
Protocol code: CA088-1007
Sponsor: Celgene Corp. (Pharmaceutical company). Phase: Therapeutic confirmatory (Phase III). Countries: Denmark (ongoing, recruiting), Spain (ongoing, recruiting), Poland (ongoing, recruiting), Greece (ongoing, recruiting), Belgium (ongoing, recruiting), Hungary (ongoing, recruiting), France (ongoing, recruiting), Netherlands (ongoing, recruiting), Norway (ongoing, recruiting), Portugal (ongoing, recruiting), Germany (ongoing, recruiting), Finland (ongoing, recruiting), Austria (ongoing, recruiting), Italy (ongoing, recruiting), Sweden (authorised, recruiting), Czechia (ongoing, recruiting), Romania (ongoing, recruiting).
Therapeutic area(s): Diseases [C] - Neoplasms [C04]
Gender: Female, Male. Age: 18-64 years, 65+ years. Enrolment: 189.
Start date (EU): 2025-04-17. Decision date: 2025-03-31. Results received: No. Last updated: 2026-08-04.
Decision dates by country: SE: 2025-04-24, NO: 2025-04-24, PT: 2025-04-24, ES: 2025-04-02, DK: 2025-03-31, GR: 2025-03-31, CZ: 2025-04-01, AT: 2025-04-07, BE: 2025-03-31, FI: 2025-04-08, FR: 2025-04-07, DE: 2025-04-04, HU: 2025-04-04, IT: 2025-04-24, RO: 2025-04-07, NL: 2025-04-03, PL: 2025-04-06

Condition(s): Relapsed or Refractory and Lenalidomide exposed Multiple Myeloma
Product: POMALIDOMIDE, CYCLOPHOSPHAMIDE, POMALIDOMIDE, DEXAMETHASONE SODIUM PHOSPHATE, DEXAMETHASONE, CYCLOPHOSPHAMIDE, TOCILIZUMAB, FLUDARABINE PHOSPHATE, DEXAMETHASONE, DEXAMETHASONE, FLUDARABINE PHOSPHATE, CARFILZOMIB, POMALIDOMIDE, DEXAMETHASONE SODIUM PHOSPHATE, DEXAMETHASONE, POMALIDOMIDE, DEXAMETHASONE, DARATUMUMAB, GPRC5D-TARGETED CAR T

Primary endpoint: Progression free survival (PFS): The average time participants are alive without their MM getting worse after starting the study., Minimal residual disease (MRD)-negative, complete response (CR): No signs of MM can be found in the participant’s body.
Endpoint(s): Overall survival (OS): The average time participants are alive after starting the study., Overall response rate (ORR): How many participants show a positive response to treatment.

Source: https://euclinicaltrials.eu/ctis-public/view/2024-515279-37-00